EU clinical trial 2025-524366-21-00: A Phase 3, Open-Label, Randomized Study of Sonrotoclax (BGB-11417) plus Zanubrutinib (BGB-3111) Compared with Venetoclax plus Acalabrutinib in Patients with Previously Untreated Chronic Lymphocytic Leukemia
Protocol code: BGB-11417-304
Sponsor: BeOne Medicines I GmbH (Pharmaceutical company). Phase: Therapeutic confirmatory (Phase III). Countries: Netherlands (ongoing, recruiting), Poland (ongoing, recruiting), Italy (ongoing, recruiting), Germany (ongoing, recruiting), Spain (ongoing, recruiting), Romania (ongoing, recruiting), Czechia (ongoing, recruiting), France (ongoing, recruiting), Sweden (ongoing, recruiting).
Therapeutic area(s): Diseases [C] - Neoplasms [C04]
Gender: Female, Male. Age: 18-64 years, 65+ years. Enrolment: 186.
Status: Ongoing, recruiting. Start date (EU): 2026-04-29. Decision date: 2026-04-20. Results received: No. Last updated: 2026-06-19.
Decision dates by country: CZ: 2026-04-21, DE: 2026-04-21, RO: 2026-04-24, ES: 2026-04-24, PL: 2026-04-23, IT: 2026-04-27, FR: 2026-04-27, NL: 2026-04-21, SE: 2026-04-22

Condition(s): treatment-naive Chronic Lymphocytic Leukemia
Product: Venclyxto 50 mg film-coated tablets, BGB-11417, Venclyxto 10 mg film-coated tablets, BGB-11417, Zanubrutinib, Calquence 100 mg film-coated tablets, BGB-11417, BGB-11417, Venclyxto 100 mg film-coated tablets

Primary endpoint: • PFS, defined as time from the date of randomization to the date of disease progression as determined by IRC or death due to any cause, whichever occurs first.
Endpoint(s): • uMRD4 rate defined as the proportion of patients that achieved uMRD4 measured in both PB and BMA at the PTFU1 Visit based on next-generation sequencing (NGS [clonoSEQ]), • PFS as determined by IRC in high-risk patients that have unmutated IGHV and/or TP53 aberrations (del(17p) present and/or TP53 mutated), • OS, defined as time from the date of randomization to the date of death due to any cause, • ORR defined as the proportion of patients with a CR, CRi, nodular partial response (nPR), or partial response (PR) per the IRC assessment, • uMRD5 rate defined as the proportion of patients that achieved uMRD5 measured in both PB and BMA at the PTFU1 Visit based on NGS (clonoSEQ), • Adverse events (AEs), adverse events of clinical interest (AECIs), serious adverse events (SAEs), changes from baseline in clinical laboratory tests, physical examinations, and vital signs, • PFS determined by investigator assessment, • Overall CRR determined by IRC and by investigator assessment., • ORR determined by investigator assessment, • Duration of response (DOR; determined by both IRC and investigator assessment) defined as the time from first qualifying response (CR, CRi, nPR, or PR) until disease progression or death, • Time to next treatment (TTNT) defined as the time from randomization to the start of next treatment for CLL, • Patient-reported symptoms of global health status (GHS), role functioning, and physical functioning, symptom burden, and physical condition/fatigue measured by European Organization for Research and Treatment of Cancer quality of life questionnaire EORTC IL-409

Source: https://euclinicaltrials.eu/ctis-public/view/2025-524366-21-00